EU clinical trial 2024-514703-34-00: Screening for occult malignancy using 18F-Fluorodeoxyglucose Positron Emission Tomography/Computed Tomography (FDG PET/CT) in patients with unprovoked venous thromboembolism
Protocol code: 29BRC20.0021
Sponsor: Centre Hospitalier Regional Et Universitaire De Brest (Hospital/Clinic/Other health care facility). Phase: Therapeutic confirmatory (Phase III). Countries: France (ongoing, recruitment ended).
Therapeutic area(s): Analytical, Diagnostic and Therapeutic Techniques and Equipment [E] - Diagnosis [E01]
Gender: Female, Male. Age: 18-64 years, 65+ years. Enrolment: 638.
Status: Ongoing, recruitment ended. Start date (EU): 2020-09-08. Decision date: 2024-06-18. Results received: No. Last updated: 2024-06-18.

Condition(s): Thromboembolic event, Cancer
Product: GalliaPharm, 0,74 à 1,85 GBq, générateur radiopharmaceutique

Primary endpoint: Occult cancer “missed” by cancer screening defined as proven cancer diagnosed (either biopsy proven cancer or cancer diagnosis approved by adjudication committee in the absence of biopsy proven cancer) from the time of cancer screening completion to the end of the 1-year follow-up period, and not detected at the time of screening.
Endpoint(s): 1) New cancer diagnosis after completion of the initial allocated screening strategy., 2) Early-stage (T1-2N0M0 as per the World Health Organization TNM classification system) and advanced-stage tumors at initial screening and during follow-up., 3) Cancer-related mortality during a 5-year follow-up period., 4) Diagnosis of cancer and costs from the viewpoint of the healthcare system over a one-year period in order to estimate the additional cost per additional cancer detected and the incremental cost utility ratio, 5) Additional tests following each strategy and during follow-up., 6) The data of this study will be used to develop a decision aid to assist future patients in the decision of cancer screening

Source: https://euclinicaltrials.eu/ctis-public/view/2024-514703-34-00